EU clinical trial 2024-511382-11-00: A Phase II, double-blind, randomized, multiple dose, cross over, three-treatment, three-period, six sequence placebo controlled trial to evaluate efficacy, pharmacokinetics (PK), pharmacodynamics (PD) and safety and tolerability of glycopyrronium (bromide) in children from 6 to less than 12 years of age with asthma
Protocol code: CQVM149C2201
Sponsor: Novartis Pharma AG (Pharmaceutical company). Phase: Therapeutic exploratory (Phase II). Countries: Bulgaria (ongoing, recruiting), Hungary (ongoing, recruiting), Poland (ongoing, recruiting), Spain (ongoing, recruiting).
Therapeutic area(s): Diseases [C] - Respiratory Tract Diseases [C08]
Gender: Female, Male. Age: 0-17 years. Enrolment: 30.
Status: Ongoing, recruiting. Start date (EU): 2022-08-29. Decision date: 2024-06-13. Results received: No. Last updated: 2026-06-29.
Decision dates by country: ES: 2024-06-18, HU: 2024-06-13, PL: 2024-06-21, BG: 2024-06-14

Condition(s): Asthma
Product: SALBUTAMOL, SALMETEROL XINAFOATE, FLUTICASONE PROPIONATE, NVA237, NVA237, The Placebo is a generic Placebo, inhalation powder, hard capsule. It is used to match an active dosage forms (NVA237 12.5µg and NVA 237 25µg) in this clinical trial. The placebo comprises inactive excipients (magnesium stearate and lactose monohydrate) encapsulated in hard non-gelatin capsules matching those used for the active drug product.

Primary endpoint: Change from Baseline in trough FEV1 at week 2 of each treatment period
Endpoint(s): Steady state pharmacokinetic (PK) concentration profiles and parameters for each glycopyrronium dose level as feasible, Change from Baseline (morning and evening) in PEF rate averaged over 2 weeks of each treatment period, Change from Baseline in FEV1 at 30 min and 1 hour post dose at week 2 of each treatment period, Change from baseline in rescue medication use over 2 weeks of each treatment period 1. Adverse events (AEs), electrocardiograms (ECGs), vital signs 2. Laboratory parameters including blood glucose and serum potassium levels, Adverse events of special interest (AESI) typical of anti-muscarinic side effects (including dry mouth, fatigue, constipation, and urinary retention)

Source: https://euclinicaltrials.eu/ctis-public/view/2024-511382-11-00